EU clinical trial 2023-507688-20-00: A Phase 3, Randomized, Double-blind Study of Adjuvant Immunotherapy with Nivolumab + Relatlimab Fixed-dose Combination versus Nivolumab Monotherapy after Complete Resection of Stage III-IV Melanoma
Protocol code: CA224-098
Sponsor: Bristol Myers Squibb International Corporation (Pharmaceutical company). Phase: Therapeutic confirmatory (Phase III). Countries: Czechia (ended), Denmark (ended), Belgium (ended), Finland (ended), Germany (ended), Italy (ended), Greece (ended), Norway (ended), Sweden (ended), Romania (ended), Austria (ended), France (ended), Spain (ended).
Therapeutic area(s): Diseases [C] - Neoplasms [C04]
Gender: Female, Male. Age: 0-17 years, 18-64 years, 65+ years. Enrolment: 601.
Status: Ended. Start date (EU): 2021-12-03. End date (EU): 2025-03-24. End date: 2025-04-02. Decision date: 2024-02-07. Results received: Yes. Last updated: 2025-03-03.
Decision dates by country: BE: 2024-02-12, CZ: 2024-02-09, DK: 2024-02-07, DE: 2024-02-09, GR: 2024-03-07, RO: 2024-02-09, ES: 2024-02-07, SE: 2024-02-09, NO: 2024-02-07, FR: 2024-04-24, AT: 2024-03-07, FI: 2024-02-07, IT: 2024-03-11

Condition(s): Participants with completely resected Stage III or Stage IV melanoma
Product: Nivo 240 mg and Rela 80 mg per vial, OPDIVO 10 mg/mL concentrate for solution for infusion.

Primary endpoint: RFS time as assessed by the investigator. RFS is defined as the time between the date of randomization and the first date of documented recurrence (local, regional, distant, new primary melanoma), or death due to any cause, whichever occurs first. Comparison of relatlimab and nivolumab FDC vs nivolumab monotherapy.
Endpoint(s): OS is defined as the time between the date of randomization and the date of death due to any cause. Comparison of relatlimab and nivolumab FDC vs nivolumab monotherapy., DMFS, by investigator, is defined as the time between the date of randomization and the date of first distant metastasis or date of death due to any cause, whichever occurs first. Comparison of relatlimab and nivolumab FDC vs nivolumab monotherapy., Incidence and severity of AE, SAEs, AEs leading to DC, IMAEs, drugrelated AEs, deaths, laboratory abnormalities, and other select AEs, in all treated participants., PFS2 defined as time from randomization to second recurrence/objective disease progression on next-line systemic therapy per investigator, or death from any cause, whichever occurs first. Evaluation of relatlimab and nivolumab FDC vs nivolumab monotherapy.

Source: https://euclinicaltrials.eu/ctis-public/view/2023-507688-20-00